EU clinical trial 2024-512039-66-00: An Open-label, Multicenter Clinical Study to Evaluate the Efficacy and Safety of Inhaled Molgramostim in Pediatric Subjects with Autoimmune Pulmonary Alveolar Proteinosis (aPAP)
Protocol code: SAV006-04
Sponsor: Savara ApS (Pharmaceutical company). Phase: Therapeutic confirmatory (Phase III). Countries: Germany (ongoing, recruiting).
Therapeutic area(s): Diseases [C] - Respiratory Tract Diseases [C08]
Gender: Female, Male. Age: 0-17 years. Enrolment: 5.
Status: Ongoing, recruiting. Start date (EU): 2025-09-11. Decision date: 2025-04-24. Results received: No. Last updated: 2026-07-17.

Condition(s): Autoimmune pulmonary alveolar proteinosis
Product: Molgradex

Primary endpoint: Change in Hb-adjusted % predicted DLCO from Baseline to Week 24.
Endpoint(s): Change in Hb-adjusted % predicted DLCO from Baseline to Week 48., Absolute change from Baseline in oxygen saturation (SpO2) at rest after 24 and 48 weeks of treatment., Absolute change from Baseline in 6-minute walk distance (6MWD) after 24 and 48 weeks of treatment., Change from Baseline in Pediatric Quality of Life (PedsQLTM) Generic Core Scale score after 24 and 48 weeks of treatment., AEs, including clinically significant findings on pulmonary function tests and safety laboratory assessments and adverse events of special interest (AESIs; hypersensitivity and chest pain)., Titers of anti-GM-CSF antibodies at Baseline and after 4, 12, 24, 48, and 52 weeks., Change from Baseline in forced expiratory volume in one second (FEV1) (% predicted) and forced vital capacity (FVC) (% predicted) after 24 and 48 weeks of treatment.

Source: https://euclinicaltrials.eu/ctis-public/view/2024-512039-66-00